EU clinical trial 2024-517170-20-01: Lithium versus cariprazine in the acute phase treatment of bipolar depression: a pragmatic head-to-head open, randomized multicenter study. The 9th study of the Danish University Antidepressant Group (DUAG 9)
Sponsor: Aalborg University Hospital (Hospital/Clinic/Other health care facility). Phase: Therapeutic use (Phase IV). Countries: Denmark (ongoing, recruiting).
Therapeutic area(s): Psychiatry and Psychology [F] - Mental Disorders [F03]
Gender: Female, Male. Age: 18-64 years. Enrolment: 122.
Status: Ongoing, recruiting. Start date (EU): 2022-12-13. Decision date: 2024-10-02. Results received: No. Last updated: 2026-02-27.

Condition(s): Depressive episode in bipolar disorder
Product: Reagila 1.5 mg hard capsules, LITHIUM

Primary endpoint: investigate whether cariprazine is superior to lithium or vice versa in the acute treatment of patients with bipolar type 1 or 2 in a current depressive episode measured as change on the Hamilton Depression Scale, 6 item version, HDS-6.
Endpoint(s): Difference-in-differences for secondary continuous measures: Hamilton Depression Scale, 17 item version, HDS-17. (Values 0- 52, higher scores mean a worse outcome)., Difference-in-differences (baseline to 8 weeks) in HDS-6 for the PP 8 population., Between-groups difference in proportion of responders and remitters at week 4 and 8 in HDS-6 scores., Between-groups difference in proportion of responders and remitters with response and remission defined by HDS-6 score without clinical relevant manic symptoms (MAS <7) at planned or premature endpoint., Between-groups difference in the proportion of patients with 'acceptable wellbeing', defined as the subject reporting ≥50 on the WHO-5 questionnaire at endpoint. WHO-five Well-being Index, WHO-5, Between-groups difference in the proportion of patients with 'acceptable wellbeing', defined as the subject reporting ≥50 on the WHO-5 questionnaire at endpoint. WHO-five Well-being Index, WHO-5., Between-groups difference in "(switch to mania or hypomania) / (response) -ratio", defined as the number of subjects switching to mania or hypomania (as defined above) divided by the total number of responders, including those responders switching to mania., Between-group differences in reason for and time to all cause treatment discontinuation (lack of effect, lack of tolerability, lost to follow-up, or other cause)., Between-group difference in treatment compliance. Treatment compliance is defined as the proportion of received treatments out of the planned until drop-out or end of study., Between-group difference for the ITT population in reasons for premature discontinuation., Difference-in-differences for secondary continuous measures: MAS Bech-Rafaelsens Mania scale .(Values 0- 44, higher scores mean a worse outcome)., Difference-in-differences for secondary continuous measures: MES Bech-Rafaelsens Melancholia scale, MES .(Values 0- 44, higher scores mean a worse outcome)., Difference-in-differences for secondary continuous measures: MADRS Montgomery-Aaberg Depression Rating Scale, MADRS .(Values 0- 60, higher scores mean a worse outcome)., Difference-in-differences for secondary continuous measures:YMRS Young Mania Rating Scale, YMRS .(Values 0- 60, higher scores mean a worse outcome)., Difference-in-differences for secondary continuous measures:ASRM-14 Altman Self-Rating Mania Scale-14, .(Values 0- 56, higher scores mean a worse outcome)., Difference-in-differences for secondary continuous measures:MDI Major Depression Inventory, MDI (Values 0- 58, higher scores mean a worse outcome)., Difference-in-differences for secondary continuous measures: WHO-5 questionnaire., Difference-in-differences for secondary continuous measures: SCIP Screen for Cognitive Impairment in Psychiatry, SCIP (Values 0- 64+, higher scores mean a better outcome)., Difference-in-differences for secondary continuous measures: COBRA Cognitive complaints in bipolar disorder Ratings assessment, COBRA, (Values 0- 48, higher scores mean a worse outcome)., Difference-in-differences for secondary continuous measures: FAST Functioning Assessment Short Test, FAST (Values 0 - 72, higher scores mean a worse outcome)., Difference-in-differences for secondary continuous measures:PSQI PIttsburgh Sleep Quality Index, PSQI (Values 0 - 21, higher scores mean a worse outcome)., Difference-in-differences for secondary continuous measures: CGI-S Clinical Global Impression Scale - Severity, CGI-S (Values 1 -7, higher scores mean a worse outcome)., Difference-in-differences for secondary continuous measures:CGI-I Clinical Global Impression Scale - Global Improvement CGI- I (Values 1 -7, higher scores mean a worse outcome)., Difference-in-differences for secondary continuous measures: C-SSRS Columbia-Suicide Severity Rating Scale, C-SSRS (Values 1 - 5, higher scores mean a worse outcome)., Difference-in-differences for secondary continuous measures: accumulated benzodiazepine dose as diazepam equivalents (DSKP)., Difference-in-differences for secondary continuous measures: for time to all-causes discontinuation., Difference-in-differences for secondary continuous measures: all-causes study endpoint., Between-group difference for the ITT population in reasons for time to all cause discontinuation., Between-group difference for the ITT population in reasons for treatment expectation., Between-group difference for the ITT population in reasons for adverse events., Between-group difference for the ITT population in reasons for serious adverse events.

Source: https://euclinicaltrials.eu/ctis-public/view/2024-517170-20-01